EU clinical trial 2023-510480-35-00: SIRAVA: Five-year boostability after single-visit single-dose intramuscular rabies pre-exposure prophylaxis
Sponsor: Academisch Ziekenhuis Leiden (Hospital/Clinic/Other health care facility). Phase: Therapeutic use (Phase IV). Countries: Netherlands (ongoing, recruiting).
Therapeutic area(s): Diseases [C] - Virus Diseases [C02]
Gender: Female, Male. Age: 18-64 years. Enrolment: 240.
Status: Ongoing, recruiting. Start date (EU): 2024-09-19. Decision date: 2024-09-19. Results received: No. Last updated: 2024-09-19.

Condition(s): viral infections
Product: Rabipur poeder en oplosmiddel voor oplossing voor injectie in een voorgevulde spuit.Rabiësvaccin (geïnactiveerd).

Primary endpoint: The primary endpoint is the rate of increase of geometric mean concentrations (GMC) of neutralizing antibodies between day 1 and day 8 after revaccination
Endpoint(s): Percentage of subjects with RVNA titer >0.5 IU/mL at D1, D57 or D64, Y1, Y2 and Y5 after primary vaccination., Percentage of subjects with RVNA titer >0.5 IU/mL at D1, D8 and D15 after the simulated post-exposure vaccination, Percentage of subjects with RVNA titer >3 IU/mL, and percentage of subjects with RVNA titers >5 IU/mL at day 8 after simulated PEP., GMCs at D1, D57 or D64, Y1, Y2 and Y5 after primary vaccination, and at D1, D8 and D15 after the simulated post-exposure vaccination

Source: https://euclinicaltrials.eu/ctis-public/view/2023-510480-35-00